EU clinical trial 2023-508533-14-00: Phase III, Open-label Trial to Evaluate Pharmacokinetics, Pharmacodynamics, Safety, Efficacy, and Immunogenicity of Benralizumab in Children with Eosinophilic Disease (CLIPS)
Protocol code: D3255C00004
Sponsor: AstraZeneca AB (Pharmaceutical company). Phase: Therapeutic confirmatory (Phase III). Countries: Poland (authorised, recruitment pending), Netherlands (authorised, recruiting), France (authorised, recruitment pending).
Therapeutic area(s): Diseases [C] - Immune System Diseases [C20]; Diseases [C] - Hemic and Lymphatic Diseases [C15]
Gender: Female, Male. Age: 0-17 years. Enrolment: 7.
Start date (EU): 2026-07-13. Decision date: 2026-06-30. Results received: No. Last updated: 2026-07-06.
Decision dates by country: FR: 2026-06-30, NL: 2026-06-30, PL: 2026-07-06

Condition(s): Eosinophilic Disease
Product: Benralizumab, Fasenra 30 mg solution for injection in pre-filled syringe

Primary endpoint: All cohorts: Nimber of Participants with Adverse Events (AEs), All cohorts:Serum Concentrations of Benralizumab
Endpoint(s): All cohorts: Presence and characterisation of ADA, All cohorts:Change From Baseline in Peripheral Blood Eosinophil Count, EGPA Cohort: Proportion of participants in remission at Week 24, with remission defined as PVAS = 0 and OCS intake ≤ 0.1 mg/kg/day., EGPA Cohort:Time from enrolment to first EGPA relapse, where relapse is defined as any of the following:a)Active vasculitis(PVAS > 0);OR b)Worsening of asthma symptoms (based on Asthma Control Questionnaire - Interviewer Administered [ACQ-IA]); OR c) Active nasal and/or sinus disease with worsening in at least one sino-nasal symptom question warranting any of the following: 1) Increase OCS; OR 2) Increase/addition of immunosuppressive medication; OR 3) Hospitalisation related to EGPA wors, HES Cohort:-Time to first HES worsening/flare during the Treatment Period -Proportion of participants who experience a HES worsening/flare during the treatment period - Number of HES worsening/flares (annualised rate/year) during the treatment period, HES Cohort: Number and proportion of participants who require an increase in corticosteroid dose from baseline at any point in the Treatment Period, HES Cohort:-Time to first haematologic relapse (AEC ≥ 1000 cells/μL) during the treatment period - Proportion of participants who have haematologic relapse duringthe treatment period - Number and proportion of participants who have AEC < 500 cells/μL for 24 weeks during the treatment period, HES Cohort: PGI-C during the treatment period

Source: https://euclinicaltrials.eu/ctis-public/view/2023-508533-14-00